EU clinical trial 2022-502630-71-00: A Phase 4, Multicenter, 2-part Study Composed of a Randomized, Double-blind, Parallel-group, Placebo-controlled, Active-comparator, Dose-optimization Evaluation followed by a Open-label Evaluation to Assess the Safety and Efficacy of Guanfacine Hydrochloride Prolonged-release (SPD503) in Children and Adolescents aged 6 to 17 Years with Attention-deficit/Hyperactivity Disorder
Protocol code: SPD503-401
Sponsor: Takeda Development Center Americas Inc. (Pharmaceutical company). Phase: Therapeutic use (Phase IV). Countries: Sweden (ended), Netherlands (ended), Spain (ended), Belgium (ended), Germany (ended).
Therapeutic area(s): Psychiatry and Psychology [F] - Behavioral Disciplines and Activities [F04]
Gender: Female, Male. Age: 0-17 years. Enrolment: 68.
Status: Ended. Start date (EU): 2019-11-20. End date (EU): 2025-09-02. End date: 2025-09-02. Decision date: 2023-04-25. Results received: Yes. Last updated: 2025-07-31.
Decision dates by country: SE: 2023-04-25, NL: 2023-05-23, DE: 2023-06-06, BE: 2023-05-17, ES: 2023-04-26

Condition(s): Attention-deficit/hyperactivity disorder (ADHD)
Product: Intuniv 3 mg prolonged-release tablets, Intuniv 4 mg prolonged-release tablets, Identical to Intuniv 1mg., Intuniv 2 mg prolonged-release tablets, Identical to Intuniv 3mg, ATOMOXETINE HYDROCHLORIDE, Identical to atomoxetine hydrochloride 10mg, 18mg, 25mg, 40mg and 60mg., ATOMOXETINE HYDROCHLORIDE, ATOMOXETINE HYDROCHLORIDE, Identical to Intuniv 2mg., ATOMOXETINE HYDROCHLORIDE, Identical to Intuniv 4mg., Intuniv 1 mg prolonged-release tablets, ATOMOXETINE HYDROCHLORIDE

Primary endpoint: The primary safety endpoint will be the change from baseline in the CANTAB RTI task.
Endpoint(s): Secondary safety endpoints: -CANTAB tasks: RVP, SWM between errors, DMS, and SST, Tanner stage, weight, height, BMI, Vital signs (BP and pulse) and ECG results, BPRS-C total score and scales for Depression, Anxiety, Psychomotor Excitation, Behavior Problems, Withdrawal, Thinking Disturbance, and Organicity, C-SSRS, Specified UKU side effect rating scale items: Asthenia/Lassitude/Increased Fatigability, Sleepiness/Sedation, Increased Duration of Sleep, and Orthostatic Dizziness, PDSS, Secondary efficacy endpoints: -ADHD-RS-5 total score and subscale scores for hyperactivity/impulsivity and inattention domains, CGI-I, calculated from CGI-S, CHIP-CE:PRF, C3PS Total Score and scores for Learning Problems and Executive Functioning subscales

Source: https://euclinicaltrials.eu/ctis-public/view/2022-502630-71-00